EU clinical trial 2023-505936-37-00: Nordic Urothelial Cancer Research Group Study on Reduced BCG Dwell-Time in High Risk NMIBC
Sponsor: Aarhus University Hospital (Hospital/Clinic/Other health care facility). Phase: Therapeutic use (Phase IV). Countries: Sweden (ongoing, recruitment ended), Iceland (ongoing, recruitment ended), Denmark (ongoing, recruitment ended).
Therapeutic area(s): Diseases [C] - Female Urogenital Diseases and Pregnancy Complications [C13]; Diseases [C] - Male Urogenital Diseases [C12]
Gender: Female, Male. Age: 18-64 years, 65+ years. Enrolment: 314.
Status: Ongoing, recruitment ended. Start date (EU): 2021-02-03. Decision date: 2023-07-27. Results received: No. Last updated: 2026-01-09.
Decision dates by country: IS: 2023-08-02, SE: 2023-07-27, DK: 2023-09-13

Condition(s): Urothelial cancer
Product: BCG-medac Pulver und Lösungsmittel zur Herstellung einer Suspension zur intravesikalen Anwendung

Primary endpoint: Number of study subjects completing all 6 induction instillations and subsequent maintenance instillations for 12 months (6+3x3)
Endpoint(s): Recurrence rate within 24 months in study subjects with initial complete response, Progression rate within 24 months and 60 months, disease specific survival within 24 months and 60 months, Overall survival 24 months and 60 months, Total number of BCG instillations per study subject, Number of study subjects completing all 6 induction instillations, Number of BCG instillations given with full dwell time of 2 hours per study subject, Number of instillations per study subject postsponed 1 week or more because of side effects, Number of study subjects where instillations is stopped because of local side effects, Number of study subjects where instillations is stopped because of systemic side effects, Number of study subjects undergoing re-induction therapy within 24 months because of recurrent or persistent disease

Source: https://euclinicaltrials.eu/ctis-public/view/2023-505936-37-00